EU clinical trial 2025-521180-13-00: PNOC023: Open Label Phase 1 and Target Validation Study of ONC206 in Children and Young Adults with Newly Diagnosed or Recurrent Diffuse Midline Glioma (DMG), and Other Recurrent Primary Malignant Central Nervous System (CNS) Tumors.
Protocol code: PNOC023
Sponsor: Prinses Maxima Centrum voor Kinderoncologie B.V. (Hospital/Clinic/Other health care facility). Phase: Human Pharmacology (Phase I)- First administration to humans. Countries: Netherlands (ongoing, recruiting).
Therapeutic area(s): Diseases [C] - Neoplasms [C04]
Gender: Female, Male. Age: 0-17 years, 18-64 years. Enrolment: 20.
Status: Ongoing, recruiting. Start date (EU): 2026-03-04. Decision date: 2025-12-08. Results received: No. Last updated: 2025-12-11.

Condition(s): Diffuse Midline Glioma (DMG), and Other Recurrent Primary Malignant Central Nervous System (CNS) Tumors
Product: ONC206 Powder

Primary endpoint: Dose escalation and expansion phase: MTD (Maximum tolerated dose); within the first 4 weeks of treatment for Arms A and D (without radiation) and the duration of radiation for Arms B and C (in combination with radiation), Target validation arms: Measurement for determining if the study drug passes the blood brain barrier and enters the tumor
Endpoint(s): Pharmacokinetic (PK) assessments for ONC206

Source: https://euclinicaltrials.eu/ctis-public/view/2025-521180-13-00